EU clinical trial 2024-517794-24-00: Evaluation of Local Co-administration of Autologous ADIpose Derived Stromal Vascular Fraction With Microfat for Refractory Perianal CROHN’s Fistulas : ADICROHN II
Protocol code: ADICROHN II
Sponsor: Centre Hospitalier Regional De Marseille (Hospital/Clinic/Other health care facility). Phase: Therapeutic exploratory (Phase II). Countries: France (ongoing, recruiting).
Therapeutic area(s): Diseases [C] - Digestive System Diseases [C06]; Phenomena and Processes [G] - Digestive System and Oral Physiological Phenomena [G10]
Gender: Female, Male. Age: 18-64 years, 65+ years. Enrolment: 84.
Status: Ongoing, recruiting. Start date (EU): 2024-10-24. Decision date: 2024-10-24. Results received: No. Last updated: 2026-03-11.

Condition(s): crohn disease
Product: Placebo SVF inj prep, SVF 2 inj prep

Primary endpoint: clinical assessment of closure (despite gentle finger compression) of all the external openings that were drained at baseline, MRI confirmation of absence of collections > 2 cm of the treated perianal fistulas at week 24
Endpoint(s): assesment of complete cessation of suppuration, significant reduction of discharge, clinical assessment of closure of all the external openings, severity of perianal Crohn’s disease (Perianal Disease Activity Index PDAI), improvement of Quality of Life Short Inflammatory Bowel Disease Questionnaire (SIBDQ) (QoL), Crohn’s Disease Activity Index (CDAI), reduction of anal incontinence severity (Wexner score), assessment of adverse events, severity, and causal relationship to study product, assessment of quantification of regulatory lymphocyte subsets and soluble inflammatory molecules, cellular composition, secretory activity and transcriptional profile, MRI charasteristics of fistula

Source: https://euclinicaltrials.eu/ctis-public/view/2024-517794-24-00